EU clinical trial 2024-511391-32-00: The COlchicine HypERtENsion Trial
Protocol code: COHERENT
Sponsor: Gentofte Hospital (Hospital/Clinic/Other health care facility). Phase: Therapeutic exploratory (Phase II). Countries: Denmark (ended).
Therapeutic area(s): Diseases [C] - Cardiovascular Diseases [C14]
Gender: Female, Male. Age: 18-64 years, 65+ years. Enrolment: 150.
Status: Ended. Start date (EU): 2021-08-10. End date (EU): 2026-01-09. Decision date: 2024-07-10. Results received: No. Last updated: 2024-07-10.

Condition(s): Cardiovascular disease, Hypertension
Product: Placebo will be identical in appearance and contain the following ingredients: lactosemonohydrate, potato starch, spiritus gelatinae 5%, magnesium stearate, talcum., Colchicin "Tiofarma", tabletter

Primary endpoint: Change in carotid-femoral pulse wave velocity at 6 months
Endpoint(s): Change in office-measured systolic blood pressure at 6 months, Change in office-measured diastolic blood pressure at 6 months, Change in LV mass index assessed by echocardiography at 6 months, Change in hs-CRP at 6 months, Change in hs-TnI at 6 months

Source: https://euclinicaltrials.eu/ctis-public/view/2024-511391-32-00